EU clinical trial 2024-517565-16-00: A Phase II, Open-Label, Single-Arm, Multicentre Study of Carboplatin, Paclitaxel, and Tislelizumab in Biomarker-Selected Patients with Resectable Locally Advanced Oral Cavity Squamous Cell Carcinoma - PERSEPHONE Trial
Sponsor: Fondazione GONO Plus (Laboratory/Research/Testing facility). Phase: Therapeutic exploratory (Phase II). Countries: Italy (ongoing, recruiting).
Therapeutic area(s): Diseases [C] - Neoplasms [C04]
Gender: Female, Male. Age: 18-64 years, 65+ years. Enrolment: 28.
Status: Ongoing, recruiting. Start date (EU): 2026-07-01. Decision date: 2025-09-15. Results received: No. Last updated: 2026-05-18.

Condition(s): Resectable Locally Advanced Oral Cavity Squamous Cell Carcinoma
Product: Paclitaxel 6 mg/ml Concentrate for Solution for Infusion, Paclitaxel 6 mg/ml Concentrate for Solution for Infusion, Carboplatin 10 mg/ml concentrate for solution for infusion, Tislelizumab, Paclitaxel 6 mg/mL concentrate for solution for infusion, Carboplatin 10 mg/ml concentrate for solution for infusion

Primary endpoint: Activity: rate of Major Pathological Response (MPR, i.e. less than 10% viable tumour cells identified on routine haematoxylin and eosin staining in pathological surgical specimen) in patients with locally advanced oral cavity squamous cell carcinoma treated with tislelizumab + carboplatin + paclitaxel in the neoadjuvant setting.
Endpoint(s): Safety: Number of adverse events and percentages, stratified for grade, of the neoadjuvant treatment with tislelizumab + carboplatin + paclitaxel measured by Common Terminology Criteria for Adverse Events (CTCAE) v 5.0., Survival a) 3-year overall survival (OS); b) 3-year disease free survival (DFS), defined as the time from treatment assignment to cancer recurrence, second cancer or death from any cause., Exploratory endpoint: To evaluate longitudinal modification in circulating-DNA (ctDNA) and immune infiltrates in tumour samples and to correlate them with pathological response after neoadjuvant therapy;, Exploratory endpoint: Identification, quantification and correlation of specific biomarkers (e.g., protein expression patterns, immune cell phenotypes) associated with treatment response, measured via IMC in pre-treatment and post-treatment tissue samples, Exploratory endpoint: Overall survival (OS), progression-free survival (PFS) and longitudinal ctDNA levels evaluated in the subgroup of patients who lack bio-molecular eligibility but meet other clinical criteria.

Source: https://euclinicaltrials.eu/ctis-public/view/2024-517565-16-00